EU clinical trial 2024-512438-14-00: Klonidin as pain relief in eye examination of premature infants - cloROP
Sponsor: Region Oerebro Laen (Hospital/Clinic/Other health care facility). Phase: Therapeutic use (Phase IV). Countries: Sweden (ongoing, recruiting).
Therapeutic area(s): Analytical, Diagnostic and Therapeutic Techniques and Equipment [E] - Anesthesia and Analgesia [E03]
Gender: Female, Male. Age: 0-17 years. Enrolment: 50.
Status: Ongoing, recruiting. Start date (EU): 2024-07-22. Decision date: 2024-07-22. Results received: No. Last updated: 2024-07-22.

Condition(s): Pain during eye examination of premature infants.
Product: CLONIDINE

Primary endpoint: PIPP-R scores within 30 seconds after the eye examination has been initiated, i.e. when the hooks are in place in the first eye in Uppsala or when the first eye is held open in Örebro.
Endpoint(s): GSR: Area small peaks, area huge peaks, peaks per second och average rise time, Number of reported AEs, SAEs and SUSARS, A VAS scale of 0-10 cm, from very easy to examin (0) to very difficult to examin (10)

Source: https://euclinicaltrials.eu/ctis-public/view/2024-512438-14-00